EU clinical trial 2023-506555-15-00: First-in-human (FIH), microdosing, non-randomized, clinical trial to investigate binding of positron emission tomography tracer [68Ga]Ga-DOTA-Cys-ATH001 targeting platelet derived growth factor receptor β in healthy subjects as compared to patients with metabolic dysfunction-associated steatohepatitis (MASH) and Primary Sclerosing Cholangitis binding (PSC, liver) and patients with fibrostenotic Crohn’s disease (CD, gastrointestinal tract [GI])
Protocol code: INT008
Sponsor: Antaros Medical AB (Pharmaceutical company). Phase: Human Pharmacology (Phase I)- First administration to humans. Countries: Sweden (ongoing, recruiting).
Therapeutic area(s): Analytical, Diagnostic and Therapeutic Techniques and Equipment [E] - Diagnosis [E01]
Gender: Female, Male. Age: 18-64 years, 65+ years. Enrolment: 36.
Status: Ongoing, recruiting. Start date (EU): 2024-08-19. Decision date: 2024-05-07. Results received: No. Last updated: 2026-07-29.

Condition(s): Primary Sclerosing Cholangitis, Crohn’s disease, Metabolic dysfunction-associated steatotic liver disease

Source: https://euclinicaltrials.eu/ctis-public/view/2023-506555-15-00